EU clinical trial 2024-512148-50-00: Open-Label, Global, Multicenter, Randomized, Phase 3 Study of Sacituzumab Govitecan Versus Docetaxel in Patients With Advanced or Metastatic Non-Small Cell Lung Cancer (NSCLC) With Progression on or After Platinum-Based Chemotherapy and Anti-PD-1/PD-L1 Immunotherapy
Protocol code: GS-US-577-6153
Sponsor: Gilead Sciences Inc. (Pharmaceutical company). Phase: Therapeutic confirmatory (Phase III). Countries: Belgium (ongoing, recruitment ended), France (ended), Spain (ended), Germany (ended), Austria (ended), Italy (ended), Netherlands (ended), Greece (ended), Portugal (ended), Poland (ended).
Therapeutic area(s): Diseases [C] - Neoplasms [C04]
Gender: Female, Male. Age: 18-64 years, 65+ years. Enrolment: 345.
Start date (EU): 2022-03-03. Decision date: 2024-06-25. Results received: No. Last updated: 2026-02-03.
Decision dates by country: AT: 2024-07-01, GR: 2024-07-22, DE: 2024-06-28, PL: 2024-07-22, NL: 2024-07-25, FR: 2024-06-28, PT: 2024-07-02, IT: 2024-07-08, ES: 2024-06-25, BE: 2024-06-27

Condition(s): Non-small cell lung cancer
Product: Docetaxel Accord 20 mg/1 ml concentrate for solution for infusion, Trodelvy 200 mg powder for concentrate for solution for infusion

Primary endpoint: OS is defined as the time from the date of randomization until death due to any cause in the Intent-to-Treat (ITT) Analysis Set.
Endpoint(s): PFS is defined as the time from the date of randomization until the date of objective disease progression or death (whichever comes first) as assessed by the investigator per RECIST Version 1.1., ORR is defined as the proportion of patientsparticipants who achieve a complete response (CR) or partial response (PR) that is confirmed at least 4 weeks later as assessed by the investigator per RECIST Version 1.1., DOR is defined as the time from the first documentation of CR or PR to the earlier of the first documentation of PD or death from any cause (whichever comes first) as assessed by the investigator per RECIST Version 1.1., DCR is defined as the proportion of patientsparticipants who achieve a CR, PR, or stable disease (SD) as assessed by the investigator per RECIST Version 1.1., Incidence of treatment-emergent adverse events (TEAEs) and clinical laboratory abnormalities., Time to first deterioration in shortness of breath domain as measured by NSCLC-SAQ., Time to first deterioration in NSCLC-SAQ total score.

Source: https://euclinicaltrials.eu/ctis-public/view/2024-512148-50-00